EU clinical trial 2023-508349-42-00: A Study to Evaluate the Safety, Pharmacokinetics, and Antitumor Activity of Furmonertinib in Patients with Non-Small Cell Lung Cancer with Activating EGFR or HER2 Mutations (FURTHER)
Protocol code: FURMO-002
Sponsor: Arrivent Biopharma Inc. (Pharmaceutical company). Phase: Human Pharmacology (Phase I)- Other. Countries: Italy (ended), Netherlands (ongoing, recruitment ended), France (ongoing, recruitment ended), Spain (ongoing, recruitment ended).
Therapeutic area(s): Diseases [C] - Neoplasms [C04]
Gender: Female, Male. Age: 18-64 years, 65+ years. Enrolment: 32.
Start date (EU): 2022-10-18. Decision date: 2024-07-11. Results received: No. Last updated: 2026-04-27.
Decision dates by country: IT: 2024-07-29, ES: 2024-07-11, FR: 2024-07-17, NL: 2024-07-11

Condition(s): Non-Small Cell Lung Cancer (NSCLC) harboring activating EGFR or HER2 kinase domain mutations

Source: https://euclinicaltrials.eu/ctis-public/view/2023-508349-42-00